EU clinical trial 2023-505436-35-00: MorningLyte: A Phase III randomized, open-label, international, multicenter study evaluating the efficacy and safety of mosunetuzumab plus lenalidomide in comparison to anti-CD20 monoclonal antibody plus chemotherapy in subjects with previously untreated FLIPI 2-5 follicular lymphoma
Protocol code: MO44842-MorningLyte
Sponsor: Lysarc (Pharmaceutical company). Phase: Therapeutic confirmatory (Phase III). Countries: Germany (ongoing, recruiting), Portugal (ongoing, recruiting), Spain (ongoing, recruiting), Belgium (ongoing, recruiting), France (ongoing, recruiting), Austria (ongoing, recruiting).
Therapeutic area(s): Diseases [C] - Neoplasms [C04]
Gender: Female, Male. Age: 18-64 years, 65+ years. Enrolment: 698.
Status: Ongoing, recruiting. Start date (EU): 2024-06-03. Decision date: 2024-04-30. Results received: No. Last updated: 2026-08-07.
Decision dates by country: ES: 2024-04-30, PT: 2024-04-30, AT: 2025-03-17, DE: 2024-04-30, FR: 2024-04-30, BE: 2024-04-30

Condition(s): Untreated FLIPI 2-5 Follicular Lymphoma
Product: Mosunetuzumab, MabThera 500 mg concentrate for solution for infusion, LENALIDOMIDE, PREDNISONE, VINCRISTINE SULFATE, CYCLOPHOSPHAMIDE, MabThera 1400 mg solution for subcutaneous injection, Mosunetuzumab, Gazyvaro 1,000 mg concentrate for solution for infusion., DOXORUBICIN HYDROCHLORIDE, LENALIDOMIDE, BENDAMUSTINE HYDROCHLORIDE, LENALIDOMIDE

Primary endpoint: Progression-free survival (PFS) assessed by IRC. PFS is defined as the time from randomization into the study to the first observation of documented disease progression or death due to any cause.
Endpoint(s): Response rate: Response will be assessed using the Lugano 2014 criteria (see appendix 8). The number and percentage of patients into each category (CR, PR, SD, PD, Not evaluated) of response will also be provided and patients without evaluation will be listed. Response will be assessed by investigator and by IRC., Best response rate: Best overall response is defined as patients who achieved a CMR or a PMR as best metabolic response to study treatment. Response will be assessed by investigator and by IRC., POD24 rate: POD24 is defined as the rate of progression of disease (POD) within 2 years of first line therapy. Progression of disease is defined as progression/relapse or death due to active lymphoma. Patients died for other reason than lymphoma without POD within 2 years and patients lost to FUP without POD within 2 years are excluded. POD24 will be assessed by investigator and by IRC., PFS assessed by investigator: See section 15.1 for definition of PFS details. The disease progression status will be assessed by investigator using the Lugano 2014 criteria (see appendix 0)., Event Free Survival (EFS): EFS is defined as the time from randomization to the date of first documented disease progression/relapse, initiation of a new anti-lymphoma treatment or death from any cause. The disease progression status will be assessed using the Lugano 2014 criteria (see appendix 8). EFS will be assessed by investigator and by IRC., Time to Next Anti-Lymphoma Treatment (TTNLT): TTNLT is defined as the time from randomization to the date of first documented administration of any new antilymphoma treatment. If a patient does not have an event, TTNLT will be censored at the time of last visit with adequate assessment. More details about censoring rules will be available in SAP., Duration of response (DoR): DoR is defined as the time from first overall response (CMR or PMR) to the date of first documented disease progression/relapse or death by any cause. DoR will be analyzed on patients who achieved a best response to study treatment. The disease progression status will be assessed using the Lugano 2014 criteria (see appendix 8). DoR will be assessed by investigator and by IRC., Overall Survival (OS): OS is defined as time from randomization to death from any cause. Patients who are alive will be censored at their last contact date. More details about censoring rules will be available in SAP.

Source: https://euclinicaltrials.eu/ctis-public/view/2023-505436-35-00